EU clinical trial 2023-507885-21-00: Open-label Extension of the ARGX-113-1802 Trial to Investigate the Longterm Safety, Tolerability, and Efficacy of Efgartigimod PH20 SC in Patients With Chronic Inflammatory Demyelinating Polyneuropathy (CIDP)
Protocol code: ARGX-113-1902
Sponsor: Argenx (Pharmaceutical company). Phase: Therapeutic exploratory (Phase II). Countries: Austria (ongoing, recruiting), Netherlands (ongoing, recruiting), Italy (ongoing, recruiting), Belgium (ongoing, recruiting), France (ongoing, recruiting), Romania (ongoing, recruiting), Germany (ended), Denmark (ongoing, recruiting), Spain (ongoing, recruiting), Poland (ongoing, recruiting), Bulgaria (ongoing, recruiting).
Therapeutic area(s): Diseases [C] - Nervous System Diseases [C10]
Gender: Female, Male. Age: 18-64 years, 65+ years. Enrolment: 88.
Start date (EU): 2020-08-18. Decision date: 2024-01-23. Results received: No. Last updated: 2026-03-30.
Decision dates by country: DE: 2024-01-25, DK: 2024-01-24, AT: 2024-02-05, RO: 2024-01-29, BG: 2024-03-26, BE: 2024-01-23, PL: 2024-02-23, ES: 2024-01-29, NL: 2024-01-26, FR: 2024-01-23, IT: 2024-02-05

Condition(s): Chronic Inflammatory Demyelinating Polyneuropathy
Product: Efgartigimod, ARGX-113

Primary endpoint: Incidence of TEAEs and SAEs by system organ class (SOC) and preferred term (PT). TEAEs and SAEs are monitored throughout the entire study duration., Incidence of clinically significant laboratory abnormalities. Blood sampling for laboratory analysis is taken at every study visit.
Endpoint(s): Efficacy; Change from baseline over time in the following scores and measurements: − Adjusted INCAT score; − MRC Sum score; − 24-item I-RODS disability scores; − Mean grip strength assessed by Martin vigorimeter; − TUG score. Percentage of patients without clinical deterioration over time, defined by adjusted INCAT increase ≥1 point compared to baseline., Immunogenicity; - Percentage of patients with and titers of binding antibodies (BAb) towards efgartigimod; and the presence of neutralizing antibodies (NAb) against efgartigimod., Pharmacokinetics; - Efgartigimod serum concentrations (during the first 48-week treatment cycle [followed by a safety follow-up period, if applicable])., Pharmacodynamics; - Changes from baseline over time of serum IgG levels (total). Efficacy, immunogenicity, pharmacokinetic and pharmacodynamic endpoints are assessed at every study visit, Additional Patient-reported Outcome; Change from baseline over time in: − Health-related quality-of-life questionnaire (EQ-5D-5L); − Brief Pain Inventory – Short Form (BPI-SF); − 9-item Treatment Satisfaction Questionnaire for Medication (TSQM-9); − Rasch-transformed-Fatigue Severity Scale (RT-FSS); − Hospital Anxiety and Depression Scale (HADS). Patient report outcomes are assessed at every study visit with the exception of visit 2 (week 4), Percentage of patients performing self-administration over time., Percentage of patients with treatment administered by caregiver over time., This is mock end point to allow the upload of the full translation of endpoint number 5., This is mock end point to allow the upload of the full translation of endpoint number 1.

Source: https://euclinicaltrials.eu/ctis-public/view/2023-507885-21-00